EU clinical trial 2024-514475-17-00: Intervertebral Disc Regeneration by Autologous Stem Cell Transplantation
Sponsor: Aarhus Universitet (Educational Institution). Phase: Phase I and Phase II (Integrated)- Other. Countries: Denmark (ongoing, recruitment ended).
Therapeutic area(s): Diseases [C] - Musculoskeletal Diseases [C05]
Gender: Female, Male. Age: 18-64 years. Enrolment: 34.
Status: Ongoing, recruitment ended. Start date (EU): 2022-11-15. Decision date: 2024-10-15. Results received: No. Last updated: 2025-05-27.

Condition(s): degenerative disc disease
Product: MSC, adipose tissue

Primary endpoint: Treatment success, pain reduction compared to control group Timeframe 2 yr, no post-intervention on treated level. No unexpected events by procedure., VAS-score, pain diary, EQ-5D, ODI, SF-36, LBPRS
Endpoint(s): MR morphology of disc: height, water content, fat and lipid, lactose, glucose, proteoglycans, collagen.

Source: https://euclinicaltrials.eu/ctis-public/view/2024-514475-17-00